EU clinical trial 2024-515163-63-00: The therapeutic potential of psilocybin in anorexia nervosa in young adults
Sponsor: Region Skane (Hospital/Clinic/Other health care facility). Phase: Therapeutic exploratory (Phase II). Countries: Sweden (authorised, recruitment pending).
Therapeutic area(s): Psychiatry and Psychology [F] - Behavior and Behavior Mechanisms [F01]; Psychiatry and Psychology [F] - Mental Disorders [F03]; Psychiatry and Psychology [F] - Psychological Phenomena [F02]
Gender: Female, Male. Age: 0-17 years, 18-64 years. Enrolment: 40.
Status: Authorised, recruitment pending. Decision date: 2025-06-18. Results received: No. Last updated: 2026-04-17.

Condition(s): Anorexia Nervosa

Primary endpoint: Incidence of adverse events (AEs) and serious adverse events (SAEs) during the trial period.
Endpoint(s): General Anxiety (GAD-2), Patient Health Questionnaire (PHQ-2), Experiences in Close Relationships – (ECR–RS), Life Satisfaction (LS), Positive & Neg Affect (PANAS), Harmony in Life (HILS), Self-compassion (Short SCS), Ten Item Pers Inv (TIPI), AN symptom severity (EDE), Response: A clinically significant improvement in weight and psychological symptoms during the treatment period., Remission: The achievement and maintenance of weight restoration and psychological well-being, with no significant symptoms of anorexia nervosa., Relapse: Defined as a composite outcome during the 6-month follow-up period

Source: https://euclinicaltrials.eu/ctis-public/view/2024-515163-63-00